EU clinical trial 2022-500266-10-00: A double-blind, randomized, placebo-controlled, interventional, multicenter, phase III clinical trial to investigate the safety and efficacy of ABCB5-positive mesenchymal stromal cells (ABCB5+ MSCs) on epidermolysis bullosa (EB)
Protocol code: allo-APZ2-EB-III
Sponsor: Rheacell GmbH & Co. KG (Pharmaceutical company). Phase: Therapeutic confirmatory (Phase III). Countries: Austria (ended), Hungary (ended), Poland (ended), Italy (ended), Germany (not authorised), Denmark (ended), Netherlands (ended), France (ended), Croatia (ended), Greece (ended), Portugal (ended), Spain (ended).
Therapeutic area(s): Diseases [C] - Skin and Connective Tissue Diseases [C17]; Diseases [C] - Congenital, Hereditary, and Neonatal Diseases and Abnormalities [C16]
Gender: Female, Male. Age: 0-17 years, 18-64 years, 65+ years. Enrolment: 119.
Status: Ended. Start date (EU): 2023-06-13. End date (EU): 2026-07-20. Decision date: 2022-12-06. Results received: No. Last updated: 2026-06-08.
Decision dates by country: DE: 2022-12-12, DK: 2023-02-16, HR: 2023-12-14, NL: 2023-03-09, AT: 2022-12-12, HU: 2022-12-09, IT: 2022-12-06, FR: 2023-03-16, PT: 2023-11-24, ES: 2023-12-05, GR: 2023-12-18, PL: 2022-12-13

Condition(s): Recessive Dystrophic Epidermolysis Bullosa(RDEB) and Junctional Epidermolysis Bullosa (JEB)
Product: Xyzal 0.5 mg/ml oral solution, Neoclarityn 5 mg film-coated tablets, Efcortesol Injection, Xyzal 5 mg film-coated tablets, Rupafin 10 mg Tablets, Solu-Decortin® H 10 mg, Rupatadine 1 mg/ml oral solution, Pipolphen 25 mg/ml oldatos injekció, Zirtek 1 mg/ml oral solution, Trimeton 10 mg/1 ml soluzione iniettabile, Loratadine 5 mg/5 ml Syrup, Dibondrin - Ampullen, Tavegil Injektionslösung 2 mg / 2 ml Wirkstoff: Clemastinfumarat, Placebo-OTS (cryomedium RGD10), Synopen 20 mg/2 ml otopina za injekciju, Fexofenadine Hydrochloride 120 mg Film-coated tablets, Lorastad 10 mg, tabletten, Neoclarityn 0.5 mg/ml oral solution, allo-APZ2-OTS, POLARAMINE 5 mg/1 ml, solution injectable, Cetirizine dihydrochloride 10 mg film-coated tablets, Methylprednisolone 1000 mg powder and solvent for solution for injection/infusion

Primary endpoint: • Proportion of subjects with RDEB ≥ 1 year with complete target wound closure at Month 6 (complete closure at Month 6a and confirmed 2 weeks later at Month 6b).
Endpoint(s): Secondary efficacy endpoints for each of the study populations RDEB ≥ 1 year, RDEB < 1 year, and JEB separately, • Proportion of subjects with complete target wound closure at each post-baseline visit (complete closure at the respective post-baseline visit and confirmed at the next visit at least 2 weeks apart);, • Change in overall wound burden (percent change in number of all recurrent and chronic Day 0 wounds per patient) at each post-baseline visit;, • Duration of target wound closure;, • Time to complete target wound closure from baseline;, • Change in pain severity assessed by FPS-R for subjects ≥ 4 years at each post-baseline visit;, • Change in pain severity assessed by FLACC scale for subjects < 4 years at each post-baseline visit;, • Change in itch severity assessed by ItchyQuant for subjects ≥ 4 years at each post-baseline visit;, • Change in overall disease activity assessed by the EBDASI activity score at each post-baseline visit;, • Change in overall disease damage assessed by the EBDASI damage score at each post-baseline visit;, • Change in quality of life assessed by the CDLQI for subjects ≥ 4 years at each post-baseline visit;, • Change in serum levels of inflammation markers at each post-baseline visit;, • Development of new wounds;, • Duration of closure of non-target wounds in overall wound burden per patient;, • Optional: change in C7 expression, presence of ABCB5+ MSCs, and presence of immune cells on skin biopsies (for RDEB subjects only)., Changes indicate changes from baseline. Secondary efficacy endpoints will be assessed at each post-baseline visit until Month 17. Data obtained until Month 6b will be used for the main analysis. In addition, changes will be determined compared to Month 6b., Safety endpoints for each of the study populations RDEB ≥ 1 year, RDEB < 1 year, and JEB separately • Anti-Human Leukocyte Antigen (Anti-HLA) antibody levels will be analyzed for assessment of immunogenicity at Month 6a, Month 12, and in case an immune reaction occurs;, • Potential immune reactions will be assessed by T-cell analysis;, • Frequency of adverse events and serious adverse events;, • Frequency of adverse events of special interest;, • Physical examination, laboratory parameters and vital signs;, • Overall survival.

Source: https://euclinicaltrials.eu/ctis-public/view/2022-500266-10-00